EU clinical trial 2023-504486-23-00: StAtins for Venous Event Reduction in Patients with Venous Thromboembolism : The SAVER Trial
Protocol code: CTO # 2095
Sponsor: Centre Hospitalier Regional Et Universitaire De Brest, Ostfold Hospital Trust, Ottawa Hospital Research Institute (Hospital/Clinic/Other health care facility, Hospital/Clinic/Other health care facility, Laboratory/Research/Testing facility). Phase: Therapeutic confirmatory (Phase III). Countries: Norway (ongoing, recruiting), France (ongoing, recruiting).
Therapeutic area(s): Diseases [C] - Cardiovascular Diseases [C14]
Gender: Female, Male. Age: 18-64 years, 65+ years. Enrolment: 750.
Status: Ongoing, recruiting. Start date (EU): 2024-05-29. Decision date: 2024-03-29. Results received: No. Last updated: 2026-03-18.
Decision dates by country: NO: 2023-07-27, FR: 2024-07-31

Condition(s): Venous thromboembolism, Pulmonary Embolism, Deep Vein Thrombosis
Product: Placebo Rosuvastatin Calcium 20 mg tablets, ROSUVASTATIN CALCIUM

Primary endpoint: Symptomatic recurrent major VTE (proximal DVT or segmental or larger PE) occurring between randomization and the end of follow-up (i.e. completion of the trial) in patients taking generic rosuvastatin.
Endpoint(s): Post-thrombotic syndrome as measured by the Villalta score, Non-major VTE; a) Distal DVT (distal to the trifurcation of the popliteal vein); b) Isolated sub-segmental PE; c) Upper Extremity DVT; d) Unusual site DVT; e) Superficial vein thrombosis, Arterial vascular events: o Fatal myocardial infarction o Non-fatal myocardial infarction o Hospitalization for unstable angina o Coronary artery revascularization o Sudden cardiac death o Ischemic stroke, All-cause mortality (no adjudication required)

Source: https://euclinicaltrials.eu/ctis-public/view/2023-504486-23-00